EU clinical trial 2025-521819-39-00: Prospective, Open-Label, Single-Center Pilot Study on the Efficacy of Daily Tadalafil in Early-Stage Parkinson’s Disease
Protocol code: TAD-PD
Sponsor: Amsterdam UMC Stichting (Patient organisation/association). Phase: Therapeutic exploratory (Phase II). Countries: Netherlands (authorised, recruiting).
Therapeutic area(s): Diseases [C] - Nervous System Diseases [C10]
Gender: Female, Male. Age: 18-64 years, 65+ years. Enrolment: 20.
Status: Authorised, recruiting. Start date (EU): 2026-03-02. Decision date: 2026-01-05. Results received: No. Last updated: 2026-01-05.

Condition(s): Parkinson's disease
Product: TADALAFIL

Primary endpoint: Change in motor symptoms using the MDS-UPDRS part III from baseline to two weeks after daily tadalafil administration.
Endpoint(s): All adverse events will be recorded during follow-up. The following specific side effects will be assessed (yes/no): 1) Headache, 2) Dyspepsia, 3) Back pain, 4) Muscle pain, 5) Flushing, 6) Nasal congestion, 7) Unwanted erections, and 8) Changes in libido. Blood pressure (mmHg) and heart rate (bpm) will be measured at baseline and after two weeks., Participant’s evaluation of the burden of the treatment after two weeks follow-up will be measured with a five-point Likert-type item., Participant’s satisfaction on the outcome of treatment after two weeks follow-up will be measured with a five-point Likert scale.

Source: https://euclinicaltrials.eu/ctis-public/view/2025-521819-39-00